EU clinical trial 2023-503313-30-01: Transtympanic sodium thiosulfate to prevent cisplatin-related hearing loss, a randomized controlled multicenter phase III trial; The SOUND trial
Sponsor: Stichting Het Nederlands Kanker Instituut-Antoni Van Leeuwenhoek Ziekenhuis (Hospital/Clinic/Other health care facility). Phase: Therapeutic confirmatory (Phase III). Countries: Netherlands (ongoing, recruiting).
Therapeutic area(s): Diseases [C] - Otorhinolaryngologic Diseases [C09]; Diseases [C] - Neoplasms [C04]
Gender: Female, Male. Age: 18-64 years, 65+ years. Enrolment: 100.
Status: Ongoing, recruiting. Start date (EU): 2025-04-14. Decision date: 2023-10-10. Results received: No. Last updated: 2025-11-05.

Condition(s): Head and Neck squamous cell carcinoma
Product: SODIUM THIOSULFATE

Primary endpoint: The percent of patients with a clinically relevant benefit of transtympanic STS injection against CIHL, defined as the change in the threshold between baseline and 3 months after treatment differs by ≥ 10 dB at any three adjacent frequencies from 0.5 to 16 kHz in favour of the STS treated ear.
Endpoint(s): Mean difference between STS- and untreated ears in threshold shift (post-treatment minus baseline hearing, in a continuous scale) at sensorineural pure tone averages (PTA) 1-2-4 kHz and 8-10-12.5 kHz in dB., The difference in sensorineural hearing loss between STS- and untreated ears based on the ASHA criteria(38): Grade A: threshold shift ≥ 20 dB at any one test frequency; Grade B: threshold shift ≥ 10 dB at 2 consecutive frequencies; Grade C: loss of response at three consecutive test frequencies where responses were previously obtained, The difference in sensorineural hearing loss between STS- and untreated ears based on the TUNE criteria (39) Grade 0: No hearing loss Grade 1a: threshold shift >10dB at PTA 8-10-12.5 kHz OR subjective hearing changes without threshold shift Grade 1b: threshold shift >10dB at PTA 1-2-4 kHz Grade 2a: threshold shift >20dB at PTA 8-10-12.5 kHz Grade 2b: threshold shift >20dB at PTA 1-2-4 kHz Grade 3: Hearing level >35dB HL at PTA 1-2-4 kHz de novo Grade 4: Hearing level >70dB HL at PTA 1-2-4, The difference in sensorineural hearing loss between the STS- and untreated ears based on the CTCAE criteria (40), Disease-specific survival, recurrence-free and overall survival measured at median 1 and 2 years after the start of treatment., 6. Quality of life/Patient-related outcome measures (PROM). Subjective hearing loss after platinum treatment. Measured by two questionnaires: a) Speech, Spatial and Qualities of Hearing scale (SSQ) compare; b) Tinnitus Handicap Inventory (THI)-12.

Source: https://euclinicaltrials.eu/ctis-public/view/2023-503313-30-01